EU clinical trial 2024-513609-29-01: Prospective, randomized, blinded, comparative study between botulinum toxin and topical capsaicin in the treatment of postmastectomy syndrome. Pilot study
Protocol code: SPM 2024
Sponsor: Fundacion Para El Fomento De La Investigacion Sanitaria Y Biomedica De La Comunitat Valenciana (Patient organisation/association). Phase: Therapeutic use (Phase IV). Countries: Spain (ended).
Therapeutic area(s): Phenomena and Processes [G] - Musculoskeletal and Neural Physiological Phenomena [G11]
Gender: Female. Age: 18-64 years, 65+ years. Enrolment: 30.
Status: Ended. Start date (EU): 2025-03-10. End date (EU): 2026-05-25. Decision date: 2024-09-04. Results received: No. Last updated: 2024-09-04.

Condition(s): Postmastectomy Syndrome
Product: XEOMIN 100 unidades polvo para solución inyectable, Qutenza 179 mg cutaneous patch

Primary endpoint: Pain assessment: Recording of pain intensity using a visual analogue scale (VAS), Characterization of the predominant pain perception: burning, stabbing pain, sensation of pressure or numbness.
Endpoint(s): Recording of side effects, Recording of the degree of patient satisfaction, Recording of concomitant analgesic medications

Source: https://euclinicaltrials.eu/ctis-public/view/2024-513609-29-01